EU clinical trial 2023-506011-18-00: A Phase 3, Randomized, Double-Blind, 52-Week, Placebo-Controlled, Efficacy and Safety Study of Povorcitinib in Participants With Nonsegmental Vitiligo
Protocol code: INCB 54707-304
Sponsor: Incyte Corp. (Pharmaceutical company). Phase: Therapeutic confirmatory (Phase III). Countries: France (ongoing, recruitment ended), Italy (ongoing, recruitment ended), Hungary (ongoing, recruitment ended), Poland (ongoing, recruitment ended), Bulgaria (ongoing, recruitment ended), Germany (ongoing, recruitment ended).
Therapeutic area(s): Diseases [C] - Skin and Connective Tissue Diseases [C17]
Gender: Female, Male. Age: 18-64 years, 65+ years. Enrolment: 281.
Status: Ongoing, recruitment ended. Start date (EU): 2024-04-17. Decision date: 2024-03-26. Results received: No. Last updated: 2025-09-22.
Decision dates by country: IT: 2024-03-27, HU: 2024-04-02, DE: 2024-05-03, FR: 2024-05-10, BG: 2024-03-29, PL: 2024-04-02

Condition(s): Vitiligo
Product: Povorcitinib, Placebo to Povorcitinib

Primary endpoint: Proportion of participants achieving ≥ 75% improvement from baseline in Face Vitiligo Area Scoring Index (F-VASI75) at Week 52.
Endpoint(s): Percentage change from baseline in Total Body Vitiligo Area Scoring Index (T-VASI) at Week 52., Proportion of participants achieving ≥ 50% improvement from baseline in Total Body Vitiligo Area Scoring Index (T-VASI50) at Week 52, Proportion of participants achieving ≥ 75% improvement from baseline in Total Body Vitiligo Area Scoring Index (T-VASI75) at Week 52, Proportion of participants achieving a Vitiligo Noticeability Scale (VNS) of "4 – A lot less noticeable" or "5 – No longer noticeable" at Week 52.

Source: https://euclinicaltrials.eu/ctis-public/view/2023-506011-18-00